EU clinical trial 2025-521487-36-00: A clinical study of MK-6916 in healthy people (MK-6916-006)
Protocol code: MK-6916-006
Sponsor: Merck Sharp & Dohme LLC (Pharmaceutical company). Phase: Human Pharmacology (Phase I)- Other. Countries: Belgium (ended).
Therapeutic area(s): Diseases [C] - Nervous System Diseases [C10]
Gender: Female, Male. Age: 18-64 years. Enrolment: 40.
Status: Ended. Start date (EU): 2025-06-02. End date (EU): 2025-10-22. End date: 2025-10-23. Decision date: 2025-05-28. Results received: No. Last updated: 2025-09-10.

Condition(s): Acute and chronic Pain

Source: https://euclinicaltrials.eu/ctis-public/view/2025-521487-36-00